EU clinical trial 2024-519233-33-00: A perspective multicenter randomized clinical trial for the safety and efficacy of flecainide compared to amiodorone for the conversion of paroxysmal atrial fibrillation in the Emergency Department in patients with coronary disease without residual ischemia and ejection fraction >35% (FLECA-ED)
Protocol code: FLECA-ED
Sponsor: Win Medica Pharmaceutical S.A. (Pharmaceutical company). Phase: Therapeutic confirmatory (Phase III). Countries: Greece (ended).
Therapeutic area(s): Diseases [C] - Cardiovascular Diseases [C14]
Gender: Female, Male. Age: 18-64 years, 65+ years. Enrolment: 200.
Status: Ended. Start date (EU): 2023-04-13. End date (EU): 2026-01-31. Decision date: 2025-01-15. Results received: No. Last updated: 2025-10-03.

Condition(s): Cardioversion of paroxysmal atrial fibrillation in the Emergency Department in patients with coronary artery disease without residual ischemia and an left ventricular ejection fraction > 35%
Product: Angoron 150 mg/3 ml amp ενέσιμο διάλυμα, FLECARDIA Διάλυμα για ένεση/έχχυση

Primary endpoint: The frequency of successful cardioversion to sinus rhythm [from the moment the drug is administered and for up to 6 hours]., The combined frequency of PVCs, NSVT, SVT, bradycardia < 50 bpm, and systolic blood pressure < 90 mmHg [from the moment the drug is administered and up to 6 hours].
Endpoint(s): The frequency of discharges from the Emergency Department in sinus rhythm [from the moment the drug is administered and for a period of up to 6 hours]., The frequency of successful cardioversion to sinus rhythm [from the moment the drug is administered and for up to 24 hours, 24-hour Holter monitoring]., Time to restoration to sinus rhythm [from the moment the drug is administered and for up to 6 hours]., The frequency of electrical cardioversion [from the moment the drug is administered and for up to 24 hours]., The frequency of arrhythmias: burden of PVCs, NSVT episodes, SVT episodes [from the moment the drug is administered and for up to 24 hours]., The frequency, severity and type of AEs [from the moment the drug is administered and for up to 30 days].

Source: https://euclinicaltrials.eu/ctis-public/view/2024-519233-33-00